EU clinical trial 2025-521737-91-00: A Phase 2, Open-Label, Multicenter, Tumor-agnostic Study of MK-1084 as Monotherapy and in Combination with Cetuximab, in Participants with KRAS G12C-Mutant, Advanced Solid Tumors (KANDLELIT-014)
Protocol code: MK-1084-014
Sponsor: Merck Sharp & Dohme LLC (Pharmaceutical company). Phase: Therapeutic exploratory (Phase II). Countries: Norway (ongoing, recruiting), Spain (ongoing, recruiting), Sweden (ongoing, recruiting), Italy (ongoing, recruiting), Denmark (ongoing, recruiting), France (authorised, recruiting), Poland (ongoing, recruiting), Germany (ongoing, recruiting), Greece (ongoing, recruiting).
Therapeutic area(s): Diseases [C] - Neoplasms [C04]
Gender: Female, Male. Age: 18-64 years, 65+ years. Enrolment: 74.
Start date (EU): 2025-11-25. Decision date: 2025-11-12. Results received: No. Last updated: 2026-05-19.
Decision dates by country: DE: 2025-11-13, FR: 2025-11-14, ES: 2025-11-17, IT: 2025-11-14, GR: 2025-11-12, NO: 2025-11-13, DK: 2025-11-12, PL: 2025-11-15, SE: 2025-11-12

Condition(s): Neoplasm malignant with KRAS G12C mutation
Product: CETUXIMAB, MK-1084, MK-1084, MK-1084, MK-1084

Primary endpoint: Objective Response Rate (ORR), Number of Participants Who Experience One or More Adverse Events (AEs), Number of Participants Who Discontinue Study Intervention Due to an AE
Endpoint(s): Overall Survival (OS), Duration of Response (DOR), Progression-free Survival (PFS)

Source: https://euclinicaltrials.eu/ctis-public/view/2025-521737-91-00